EU clinical trial 2024-517167-23-00: A Global, Randomized, Open-label, Multicenter Phase 3 Trial Evaluating BJT-778 vs Bulevirtide for the Treatment of Chronic Hepatitis Delta Infection (AZURE-2)
Protocol code: BJT-778-302
Sponsor: Mirum Pharmaceuticals Inc. (Pharmaceutical company). Phase: Therapeutic confirmatory (Phase III). Countries: Austria (ongoing, recruiting), Italy (ongoing, recruiting), Czechia (ongoing, recruiting), Romania (ongoing, recruiting), Sweden (ongoing, recruiting), Spain (ongoing, recruiting), France (ongoing, recruiting), Germany (ongoing, recruiting).
Therapeutic area(s): Diseases [C] - Virus Diseases [C02]
Gender: Female, Male. Age: 18-64 years, 65+ years. Enrolment: 141.
Status: Ongoing, recruiting. Start date (EU): 2025-08-28. Decision date: 2025-07-18. Results received: No. Last updated: 2026-07-23.
Decision dates by country: AT: 2025-07-21, CZ: 2025-07-21, IT: 2025-07-18, ES: 2025-07-22, DE: 2025-07-22, RO: 2025-07-22, SE: 2025-07-22, FR: 2025-07-22

Condition(s): Chronic Hepatitis D Infection
Product: BULEVIRTIDE, BJT-778

Primary endpoint: The proportion of participants who achieve a composite endpoint defined as undetectable HDV RNA and ALT normalization. • Undetectable HDV RNA is defined as HDV RNA < the lower limit of quantification [LLOQ], target not detected (TND) • ALT normalization is defined as a decrease in ALT from baseline to ≤ULN
Endpoint(s): 1. Safety endpoint will evaluate: • Incidence and severity of treatment-emergent adverse events (TEAE) • Proportion of participants who permanently discontinue treatment due to an adverse event Comparison with bulevirtide will include data through 48 weeks, 2. The proportion of participants who achieve the following during treatment at Weeks 24, 48, and 96: •HDV RNA ≥2 log10 IU/mL decline from baseline or undetectable •HDV RNA , 3. • Change from baseline in liver stiffness as determined by transient elastography (e.g., FibroScan) at Weeks 24, 48, and 96 • Change from baseline in APRI (AST-to-platelet ratio index) at Weeks 24, 48, and 96, • Change from baseline in CTP score at Weeks 24, 48, and 96 in cirrhotic participants • Change from baseline in Model for End-Stage Liver Disease (MELD) score at Weeks 24, 48, and 96 in cirrhotic participants, • Proportion of participants with clinical disease progression from baseline in HDV-associated liver disease at Weeks 24, 48, and 96. Progression will be determined by the Independent Data Monitoring Committee (IDMC). Comparison with bulevirtide will include data through 48 weeks., 4. Proportion of participants at Weeks 72 and 96 compared to those at Week 48 that achieve or maintain (defined as no change or improvement in) the below: • HDV RNA ≥2 log10 IU/mL decline from baseline or undetectable • HDV RNA , 5. Safety endpoints, defined above, will be compared between the first 48 weeks (Weeks 0-48) and the second 48 weeks (Week 48-96), including change in serum total bile acids., 7. • Change from baseline in Chronic Liver Disease Questionnaire-HBV (CLDQ-HBV) and Functional Assessment of Chronic Illness Therapy – Fatigue (FACIT-F) at Weeks 24, 48, and 96 • Compare change from baseline in CLDQ-HBV and FACIT-F between brelovitug and bulevirtide at Weeks 24 and 48, and at Week 48 (switch) and Week 96 (Arm 2), 6. Proportion of participants who achieve HDV RNA

Source: https://euclinicaltrials.eu/ctis-public/view/2024-517167-23-00